EU clinical trial 2024-515770-27-00: A Phase 1/2, Open-Label, Platform Study to Evaluate Safety and Efficacy of Etentamig Monotherapy or Etentamig Combinations in Subjects with Multiple Myeloma
Protocol code: M25-059
Sponsor: AbbVie Deutschland GmbH & Co. KG (Pharmaceutical company). Phase: Phase I and Phase II (Integrated)- Other. Countries: Norway (ongoing, recruiting).
Therapeutic area(s): Diseases [C] - Neoplasms [C04]
Gender: Female, Male. Age: 18-64 years. Enrolment: 10.
Status: Ongoing, recruiting. Start date (EU): 2026-04-27. Decision date: 2026-01-27. Results received: No. Last updated: 2026-02-17.

Condition(s): Multiple Myeloma
Product: LENALIDOMIDE, LENALIDOMIDE, DEXAMETHASONE, CARFILZOMIB, LENALIDOMIDE, DARATUMUMAB, LENALIDOMIDE, Etentamig, LENALIDOMIDE, LENALIDOMIDE, DEXAMETHASONE

Primary endpoint: Substudy 1: Dose-Limiting Toxicity (DLT) of Etentamig + Daratumumab and Lenalidomide (DR) in Participants with Transplant-Ineligible Newly Diagnosed Multiple Myeloma (TI NDMM), Substudy 4: DLT of Etentamig plus Lenalidomide when Given as Maintenance in Participants with TE NDMM, Substudy 3: DLT of Etentamig +Carfilzomib and Dexamethasone (Kd) Combination in Participants with Relapsed or Refractory Multiple Myeloma (RR MM), Substudy 2: DLT of Etentamig Monotherapy as Maintenance in Participants with Transplant-Eligible Newly Diagnosed Multiple Myeloma (TE NDMM), Number of Participants with Adverse Events (AE)s
Endpoint(s): Substudy 1, 2, 3, 4: Complete Response Rate, Substudy 1, 2, 3, 4: Progression Free Survival (PFS), Substudy 1, 2, 3, 4: Duration of Response (DOR), Substudy 1, 2, 3, 4: Overall Response Rate (ORR), Substudy 1, 2, 3, 4: Time-to-Progression (TTP), Substudy 1, 2, 3, 4: Minimal Residual Disease (MRD) negativity

Source: https://euclinicaltrials.eu/ctis-public/view/2024-515770-27-00